EU clinical trial 2024-516265-37-00: INTERACT stomach
Sponsor: Erasmus Universitair Medisch Centrum Rotterdam (Erasmus MC) (Hospital/Clinic/Other health care facility). Phase: Human Pharmacology (Phase I)- First administration to humans. Countries: Netherlands (ended).
Therapeutic area(s): Diseases [C] - Neoplasms [C04]
Gender: Female, Male. Age: 18-64 years, 65+ years. Enrolment: 54.
Status: Ended. End date (EU): 2025-02-17. Decision date: 2024-08-06. Results received: No. Last updated: 2024-08-06.

Condition(s): Stomach Cancer with metastasis in the peritoneum

Source: https://euclinicaltrials.eu/ctis-public/view/2024-516265-37-00